EU clinical trial 2024-514518-10-00: Randomised double-blind clinical trial of Onabotulinumtoxin A injection into the corpora cavernosa in patients with erectile dysfunction refractory to treatment with phosphodiesterase-5 inhibitors
Protocol code: BTXDE
Sponsor: Clinica Universidad De Navarra (Hospital/Clinic/Other health care facility). Phase: Therapeutic exploratory (Phase II). Countries: Spain (ongoing, recruiting).
Therapeutic area(s): Diseases [C] - Male Urogenital Diseases [C12]
Gender: Male. Age: 18-64 years. Enrolment: 114.
Status: Ongoing, recruiting. Start date (EU): 2024-10-31. Decision date: 2024-09-20. Results received: No. Last updated: 2025-12-29.

Condition(s): Erectile dysfunction
Product: SODIUM CHLORIDE SOLUTION 0.9%, BOTULINUM TOXIN

Primary endpoint: Subjective perception of rigidity

Source: https://euclinicaltrials.eu/ctis-public/view/2024-514518-10-00